EU clinical trial 2024-517601-82-00: MB-CART2019.1 in refractory MS
Protocol code: M-2024-424
Sponsor: Miltenyi Biomedicine GmbH (Pharmaceutical company). Phase: Phase I and Phase II (Integrated)- Other. Countries: Germany (ongoing, recruiting).
Therapeutic area(s): Diseases [C] - Nervous System Diseases [C10]
Gender: Female, Male. Age: 18-64 years, 65+ years. Enrolment: 25.
Status: Ongoing, recruiting. Start date (EU): 2026-04-01. Decision date: 2025-06-30. Results received: No. Last updated: 2025-11-12.

Condition(s): refractory Multiple Sclerosis

Source: https://euclinicaltrials.eu/ctis-public/view/2024-517601-82-00